EU clinical trial 2025-523083-21-00: A Phase 3 Open-label Randomized Study Assessing the Efficacy and Safety of RLY-2608 + Fulvestrant Versus Capivasertib + Fulvestrant as Treatment for PIK3CA-mutant Hormone Receptor Positive, Human Epidermal Growth Factor Receptor 2 Negative (HR+/HER2-) Locally Advanced or Metastatic Breast Cancer Following Recurrence or Progression On or After Treatment with a CDK4/6 Inhibitor
Protocol code: RLY-2608-102
Sponsor: Relay Therapeutics Inc. (Pharmaceutical company). Phase: Therapeutic confirmatory (Phase III). Countries: Hungary (authorised, recruitment pending), Spain (ongoing, recruiting), Italy (ongoing, recruiting), Belgium (ongoing, recruiting), Netherlands (ongoing, recruiting), Austria (ongoing, recruiting), Germany (ongoing, recruiting), Greece (ongoing, recruiting), Czechia (ongoing, recruiting), Denmark (ongoing, recruiting), Poland (ongoing, recruiting), Bulgaria (ongoing, recruiting), Portugal (ongoing, recruiting), France (ongoing, recruiting), Ireland (authorised, recruitment pending), Romania (authorised, recruitment pending).
Therapeutic area(s): Diseases [C] - Neoplasms [C04]
Gender: Female, Male. Age: 18-64 years, 65+ years. Enrolment: 300.
Start date (EU): 2025-12-08. Decision date: 2025-11-11. Results received: No. Last updated: 2026-07-10.
Decision dates by country: AT: 2025-11-17, BG: 2025-11-13, CZ: 2025-11-13, DK: 2025-11-11, HU: 2025-11-12, ES: 2025-11-12, NL: 2025-11-13, PL: 2025-11-15, IT: 2025-11-17, BE: 2025-11-13, GR: 2025-11-11, DE: 2025-11-13, IE: 2026-07-06, RO: 2026-06-30, FR: 2025-11-17, PT: 2025-11-11

Condition(s): PIK3CA-mutant Hormone Receptor Positive, Human Epidermal Growth Factor Receptor 2 Negative (HR+/HER2-) Locally Advanced or Metastatic Breast Cancer
Product: Fulvestrant EVER Pharma 250 mg solution for injection in pre-filled syringe, RLY-2608, TRUQAP 160 mg film-coated tablets, Fulvestrant Dr. Reddy’s 250 mg Solution For Injection in Pre-Filled Syringe, TRUQAP 200 mg film-coated tablets, Fulvestrant Dr. Reddys 250 mg solución inyectable en jeringa precargada EFG

Primary endpoint: PFS is defined as the time from randomization until radiographic progression per RECIST v1.1, or death due to any cause.
Endpoint(s): OS is defined as the time from randomization to the date of death by any cause., PFS is defined as the time from randomization until radiographic progression per RECIST v1.1, or death due to any cause., ORR is defined as the percentage of participants with CR or PR per RECIST v1.1., DOR is defined as the time from the date of first documented response per RECIST v1.1 until date of documented progression or death in the absence of disease progression., CBR is defined as the percentage of participants who achieved CR or PR at any time or SD maintained for ≥24 weeks per RECIST v1.1 (without subsequent therapy) after randomization., • Frequency, severity, timing, and relationship to RLY-2608/fulvestrant or capivasertib/fulvestrant of any AEs, SAEs, changes in vital signs, ECGs, and safety laboratory tests. All AEs and SAEs will be collected and graded according to the NCI CTCAE, Version 5.0. • Dose intensity. • Dose modification., Plasma concentrations of RLY-2608 (and its metabolites as appropriate)., Evaluation of EORTC QLQ-C30, EORTC QLQ-BR23 scale/item scores including change from baseline and time to deterioration., Health state utility data for economic evaluation will be derived by using the EQ-5D-5L health state utility index.

Source: https://euclinicaltrials.eu/ctis-public/view/2025-523083-21-00